EU clinical trial 2024-515059-39-00: Evaluation of the Efficacy of Valsartan in Slowing Down Aortic Root Dilatation in Children and Young Adults with Marfan-type Heritable Thoracic Aortic Diseases – Valsar-TAD, a randomised, double-blind, placebo-controlled multicentre trial
Protocol code: NBK154/2/2021
Sponsor: Medical University Of Gdansk (Educational Institution). Phase: Therapeutic confirmatory (Phase III). Countries: Poland (ongoing, recruiting).
Therapeutic area(s): Diseases [C] - Cardiovascular Diseases [C14]
Gender: Female, Male. Age: 0-17 years, 18-64 years. Enrolment: 180.
Status: Ongoing, recruiting. Start date (EU): 2024-02-09. Decision date: 2024-11-11. Results received: No. Last updated: 2026-06-09.

Condition(s): Marfan Syndrome Diseases related to Marfan syndrome (rare diseases with aneurysms of the thoracic aorta and dissection of the aorta), among others: Loeys-Dietz syndrome, Vascular type of Ehlers-Danlos syndrome, Arterial Tortuosity syndrome, Shprintzen-Goldberg syndrome, Neonatal form of Marfan syndrome, Aneurysms-osteoarthritis syndrome, Multi-system smooth muscle dysfunction syndrome, Familial thoracic aortic aneurysms and aortic dissections, etc.
Product: VALZEK, 80 mg, tabletki, PL2, PL1, Valsacor® 40 mg Filmtabletten

Primary endpoint: Absolute annual difference in aortic t diameter measured by transthoracic echocardiography and expressed in mm/yearroo
Endpoint(s): - annual difference in the aortic root diameter expressed in z-scores, indexed to sex and body surface area (BSA), measured by transthoracic echocardiography and expressed as z-score/year, - the absolute annual difference in aortic root diameter expressed in millimetres as assessed by angio- CT

Source: https://euclinicaltrials.eu/ctis-public/view/2024-515059-39-00